EU clinical trial 2024-517933-42-00: A blinded randomized study of ephedrine 0.15 mg/kg for reducing onset time of rocuronium 0.6 mg/kg in elderly patients (≥ 80 years)
Sponsor: Rigshospitalet (Hospital/Clinic/Other health care facility). Phase: Therapeutic use (Phase IV). Countries: Denmark (ended).
Therapeutic area(s): Analytical, Diagnostic and Therapeutic Techniques and Equipment [E] - Anesthesia and Analgesia [E03]
Gender: Female, Male. Age: 65+ years. Enrolment: 100.
Status: Ended. Start date (EU): 2025-01-13. End date (EU): 2025-10-05. Decision date: 2024-11-13. Results received: No. Last updated: 2024-11-13.

Condition(s): Elective surgery
Product: Ephedrine "Sintetica", injektionsvæske, opløsning 50 mg/ml, SALINE

Primary endpoint: Time to TOF 0 (from end of administration of rocuronium until TOF 0)
Endpoint(s): Intubating conditions assessed by IDS, Intubating conditions assessed by Fuchs-Buder scale, Occurrence of new cardiac arrythmia during induction of anaesthesia (<15 minutes after administration of ephedrine or saline), Change in mean arterial blood pressure from before induction to immediately after intubation, Time to TOF 0.9

Source: https://euclinicaltrials.eu/ctis-public/view/2024-517933-42-00